EU clinical trial 2024-520419-42-00: Prospective longitudinal study on immunogenicity, induction of cellular immune responses and safety of vaccination against HPV with the 9valent vaccine in HIV-positive women The Papillon study
Protocol code: The papillon study
Sponsor: CHU Saint Pierre (Hospital/Clinic/Other health care facility). Phase: Phase III and phase IV (Integrated). Countries: Belgium (authorised, recruitment pending).
Therapeutic area(s): Diseases [C] - Virus Diseases [C02]
Gender: Female. Age: 18-64 years. Enrolment: 169.
Status: Authorised, recruitment pending. Decision date: 2025-01-30. Results received: No. Last updated: 2025-01-30.

Condition(s): giving a commercially available vaccine to women with HIV under treatment, women living with HIV traeted by antiretroviral
Product: Gardasil 9 suspension for injection. Human Papillomavirus 9-valent Vaccine (Recombinant, adsorbed)

Primary endpoint: Rate of seroconversion of neutralizing antibodies against each HPV vaccine genotypes namely 6/11/16/18/31/33/45/52/58 among women seronegative at baseline for HPV vaccine genotypes, by measuring neutralizing antibody against the 9 vaccine genotypes of HPV at baseline, month 7. Comparison of that rate at month 7 (non inferiority defined as at least 80% of seroconversion in ARM A).

Source: https://euclinicaltrials.eu/ctis-public/view/2024-520419-42-00